EU clinical trial 2024-511925-71-00: A Randomized, Controlled, Multi-Center Study to Evaluate the Safety and Efficacy of Paltusotine in Subjects with Acromegaly Treated with Long-acting Somatostatin Receptor Ligands
Protocol code: CRN00808-09
Sponsor: Crinetics Pharmaceuticals Inc. (Pharmaceutical company). Phase: Therapeutic confirmatory (Phase III). Countries: Belgium (ended), France (ended), Hungary (ended), Bulgaria (ended), Poland (ended), Italy (ended).
Therapeutic area(s): Diseases [C] - Hormonal diseases [C19]
Gender: Female, Male. Age: 18-64 years, 65+ years. Enrolment: 20.
Status: Ended. Start date (EU): 2021-08-05. End date (EU): 2026-03-05. End date: 2026-05-29. Decision date: 2024-09-11. Results received: No. Last updated: 2026-04-10.
Decision dates by country: HU: 2024-09-11, IT: 2024-10-14, BE: 2024-09-13, BG: 2024-09-25, FR: 2024-09-19, PL: 2024-09-30

Condition(s): Acromegaly
Product: Placebo to match paltusotine tablets 20 mg, Paltusotine tablets

Primary endpoint: Proportion of subjects who maintain biochemical response in IGF-1 (≤1.0×the upper limit of normal [ULN]) at the End of the Randomized Control Phase (EOR)
Endpoint(s): Change from baseline in IGF-1, in units of ULN, to EOR, Proportion of subjects with GH <1.0 ng/mL at Week 34, out of those who had GH <1.0 ng/mL at baseline, Change from baseline in Total Acromegaly Symptoms Diary (ASD) score to EOR

Source: https://euclinicaltrials.eu/ctis-public/view/2024-511925-71-00